EU clinical trial 2024-514356-33-00: Phase 1/2 Clinical Trial of S227928, an Anti-CD74 Antibody-Drug Conjugate Targeting MCL-1, as a Single Agent and in Combination with Venetoclax in Patients with Relapsed/Refractory (R/R) Acute Myeloid Leukemia (AML), Myelodysplastic Syndrome (MDS)/AML, or Chronic Myelomonocytic Leukemia (CMML)
Protocol code: S227928
Sponsor: Institut De Recherches Internationales Servier IRIS (Pharmaceutical company). Phase: Phase I and Phase II (Integrated)- First administration to humans. Countries: Finland (ended), Germany (ended), France (ended).
Therapeutic area(s): Diseases [C] - Neoplasms [C04]
Gender: Female, Male. Age: 18-64 years, 65+ years. Enrolment: 54.
Status: Ended. Start date (EU): 2025-02-11. End date (EU): 2025-10-13. End date: 2025-10-14. Decision date: 2025-01-15. Results received: No. Last updated: 2025-08-04.
Decision dates by country: FR: 2025-01-15, DE: 2025-01-17, FI: 2025-01-21

Condition(s): "Patients with Relapsed/Refractory (R/R) Acute Myeloid Leukemia (AML), Myelodysplastic Syndrome (MDS)/AML, or Chronic Myelomonocytic Leukemia (CMML)"
Product: Powder for concentrate for solution for infusion, Venclyxto 50 mg film-coated tablets, Zyloric 300 mg Tablets, Venclyxto 10 mg film-coated tablets, Venclyxto 50 mg film-coated tablets, Venclyxto 50 mg film-coated tablets, Fasturtec 1.5 mg/ml powder and solvent for concentrate for solution for infusion., Venclyxto 10 mg film-coated tablets, Venclyxto 10 mg film-coated tablets, Venclyxto 100 mg film-coated tablets, Venclyxto 50 mg film-coated tablets, Venclyxto 10 mg film-coated tablets, Zyloric 100 mg Tablets

Primary endpoint: Phase I: Incidence and severity of dose-limiting toxicities (DLTs) of S227928 as a single agent and combined with venetoclax during the first cycle of treatment., Phase I: Incidence of adverse events (AEs) and serious adverse events (SAEs), changes in vital signs, physical examination, laboratory tests, including cardiac markers,electrocardiogram (ECG), echocardiogram (ECHO) with or without global longitudinal strain (GLS) or multigated acquisition (MUGA) scan, and cardiac magnetic resonance imaging (MRI)., Phase I: Dose reductions/interruptions/delays or study withdrawal due to AEs., Phase II: Complete Remission (CR).
Endpoint(s): Plasma concentration vs. time profile and derived PK parameters (i.e., Cmax, Tmax, AUC) of S227928, total monoclonal antibody (mAb), and unconjugated S64315 and venetoclax (when applicable), Phase I: Detection of anti-drug antibodies (ADAs) against S227928 and their titer, when applicable., Phase I: Complete remission (CR), complete remission with incomplete hematologic recovery (CRi), morphologic leukemia-free state (MLFS), CR with partial hematologic recovery (CRh), and partial remission (PR) for patients with AML and MDS/AML., Phase I: Overall survival (OS), duration of response (DOR), and time to first remission (CR or CRh or CRi) for patients with AML and MDS/AML., Phase I: Red-blood cell (RBC) and platelet transfusion independence for at least 8 weeks for patients with AML and MDS/AML., Phase I: CR, CRh, CR with limited count recovery (CRL), CR equivalent, PR, hematologic improvement (HI); overall response rate (ORR)= CR + CR equivalent + CRh + CRL+ PR + HI for patients with CMML., Phase I: Progression-free survival (PFS), event-free survival (EFS), and OS for patients with CMML., Phase II: CRi, MLFS, CRh, PR; OS, EFS, DOR, time to first remission (CR or CRi or CRh); RBC and platelet transfusion independence for at least 8 weeks for patients with AML and MDS/AML., Phase II: CRh, CRL, CR equivalent, PR, HI; ORR= CR + CR equivalent + CRh + CRL + PR + HI; PFS, EFS, and OS for patients with CMML., Phase II: Plasma concentrations vs. time profile of S227928, total mAb, unconjugated S64315, and venetoclax and derived PK parameters (i.e., Cmax, Tmax, AUC) of S227928, total mAb and unconjugated S64315., Phase II: Detection of ADAs against S22798 and their titer, when applicable., Phase II: Incidence and severity of DLTs of S227928 in combination with venetoclax; Incidence of AEs and SAEs, Phase II: changes in vital signs, physical examination, laboratory tests including cardiac markers, ECG, ECHO with or without GLS or MUGA scan, and cardiac MRI., Phase II: Dose reduction/interruptions/delays or study withdrawal due to AEs.

Source: https://euclinicaltrials.eu/ctis-public/view/2024-514356-33-00